EU clinical trial 2023-509814-12-00: OPTIMISE OPTIMIzation of treatment SElection and follow up in oligometastatic colorectal cancer – a ctDNA guided phase II randomized approach
Protocol code: KFE-2022
Sponsor: Region Midtjylland (Hospital/Clinic/Other health care facility). Phase: Therapeutic exploratory (Phase II). Countries: Denmark (ongoing, recruiting), Norway (ongoing, recruiting), Germany (authorised, recruitment pending).
Therapeutic area(s): Diseases [C] - Neoplasms [C04]
Gender: Female, Male. Age: 18-64 years, 65+ years. Enrolment: 381.
Start date (EU): 2021-09-22. Decision date: 2023-12-11. Results received: No. Last updated: 2026-01-20.
Decision dates by country: NO: 2024-09-23, DE: 2025-06-17, DK: 2023-12-11

Condition(s): Colorectal cancer with metastasis
Product: TEGAFUR, COMBINATIONS, CALCIUM FOLINATE, IRINOTECAN, OXALIPLATIN, CAPECITABINE, FLUOROURACIL

Primary endpoint: Rate of patients free from recurrent colorectal cancer at 2 years after inclusion
Endpoint(s): Rate of CTCAE grade 3-5 toxicity 6 months post-treatment, Molecular biological response to therapy after 6 months, Molecular biological disease-free survival at 1 year, Time to molecular biological recurrence, Time to radiological recurrence, Local and distant relapse, Overall survival, QoL (EQ-5D-5L, EORTC QLQ–C30 and –CR29, explorative ctDNA utility questionnaire), Cost-effective analysis

Source: https://euclinicaltrials.eu/ctis-public/view/2023-509814-12-00